EU clinical trial 2025-522683-32-00: A Phase III, Randomized, Double-Blind, Placebo-Controlled, Multicenter Study to Evaluate the Efficacy and Safety of Intravenous Prasinezumab in Participants with Early-Stage Parkinson’s Disease
Protocol code: BN44715
Sponsor: F. Hoffmann-La Roche AG (Pharmaceutical company). Phase: Therapeutic confirmatory (Phase III). Countries: France (authorised, recruitment pending), Austria (ongoing, recruiting), Portugal (ongoing, recruiting), Netherlands (ended), Poland (ongoing, recruiting), Germany (ongoing, recruiting), Spain (ongoing, recruiting), Denmark (ongoing, recruiting), Italy (ongoing, recruiting).
Therapeutic area(s): Diseases [C] - Nervous System Diseases [C10]
Gender: Female, Male. Age: 18-64 years, 65+ years. Enrolment: 405.
Start date (EU): 2026-01-15. Decision date: 2025-12-23. Results received: No. Last updated: 2026-06-22.
Decision dates by country: AT: 2025-12-29, FR: 2026-01-07, IT: 2025-12-23, ES: 2026-01-12, NL: 2026-01-12, PL: 2026-01-04, DK: 2025-12-23, PT: 2025-12-30, DE: 2026-01-06

Condition(s): Early-Stage Parkinson’s Disease (PD)
Product: Placebo Prasinezumab, RO7046015

Primary endpoint: Time to a confirmed motor progression event on MDS‑UPDRS Part III score from the randomization date
Endpoint(s): Change in motor function from baseline at Week 104, as measured by the MDS-UPDRS Part III off medication score, Time to worsening of participants’ motor function as reported by the participant in the presence of a confirmed motor progression event, Time to meaningful worsening in CGI-C, Overall Disease Subscale, Time to increase in LEDD, Nature, incidence, seriousness and severity of adverse events, with severity determined according to the National Cancer Institute Common Terminology Criteria for Adverse Events (NCI CTCAE) v5.0, Incidence of adverse events of special interest, Incidence of treatment discontinuation due to adverse events, Nature, incidence, seriousness, severity and timing of IRRs, Mean change in vital signs from baseline over time and incidence of abnormal vital sign measurements, Nature and incidence of abnormal ECG assessments, Change from baseline, shift tables, and incidence of laboratory abnormalities (including hematology, clinical chemistry, coagulation, and urinalysis parameters), Summary statistics of participants with suicidal ideation or behavior as assessed by Columbia Suicide Severity Rating Scale (C-SSRS) score, including detailed focus on any individual cases identified as having severe ideation or behavior during the study conduct, Serum concentration of prasinezumab or PK parameters at specified timepoints, Prevalence of anti-drug antibodies (ADAs) at baseline and incidence of ADAs during the study

Source: https://euclinicaltrials.eu/ctis-public/view/2025-522683-32-00